EU clinical trial 2024-516905-22-00: Induction therapy with bortezomib, melphalan and prednisone (VMP) followed by lenalidomide and dexamethasone (Rd) vs. carfilzomib, lenalidomide and dexamethasone (KRd) with/without daratumumab, 18 cycles, followed by consolidation and maintenance with lenalidomide and daratumumab: a phase III, multicenter, randomized clinical trial for older adult patients between 65 and 80 years old, in good general health with newly-diagnosed multiple myeloma
Sponsor: Fundacion PETHEMA (Patient organisation/association). Phase: Therapeutic confirmatory (Phase III). Countries: Spain (ongoing, recruitment ended).
Therapeutic area(s): Diseases [C] - Neoplasms [C04]
Gender: Female, Male. Age: 65+ years. Enrolment: 462.
Status: Ongoing, recruitment ended. Start date (EU): 2018-10-22. Decision date: 2024-10-25. Results received: No. Last updated: 2025-05-02.

Condition(s): Multiple myeloma
Product: DEXAMETHASONE, LENALIDOMIDE, DARATUMUMAB, CARFILZOMIB, LENALIDOMIDE, MELPHALAN, LENALIDOMIDE, PREDNISONE, VELCADE 3.5 mg powder for solution for injection, LENALIDOMIDE

Primary endpoint: The difference between each experimental arm and the control group in terms of immunphenotypic complete response (MRD negative by cytometry) after 18 cycles of induction therapy. Evaluation will be carried out using next generation flow cytometry through a study developed by the EuroFlow Consortium in accordance with response guidelines recently proposed by the IMWG [3].
Endpoint(s): Difference between each experimental arm and the control group in terms of the probability of Progression Free Survival from the date of randomization until progression or death, midway through induction (9 cycles) at the end of induction (18 cycles), post-consolidation, and yearly during maintenance. As well, differences in terms of of probability of SLP2, TTP, OS and proportions of standard response (stringent CR, CR, VGPR and PR)., Kinetics of MRD elimination after: a. 9 cycles (midway through induction). b. 18 cycles (end of induction, primary endpoint). c. post-consolidation d. yearly during maintenance therapy, for at least five years., The evaluation of MRD using NGF will allow us to evaluate: a. 3.a The difference between each experimental group and the control group in terms of proportion of immunphenotypic complete response (MRD negativity by cytometry) after 9 cycles of induction therapy., The evaluation of MRD using NGF will allow us to evaluate: 3.b Reduction in MRD levels in patients treated in the control group, as well as in patients who receive KRd without daratumumab between the end of induction therapy and the end of consolidation therapy In addition, the difference in the levels of MRD between the two above-mentioned arms at the end of short consolidation therapy (22 months) and the KRd+ daratumumab arm at the end of a prolonged period of induction therapy (18 months)., The evaluation of MRD using NGF will allow us to evaluate:3 .c Difference, evaluated yearly after the start of maintenance therapy, in preservation of response obtained after consolidation in both patients with negative MRD and those with positive MRD., Correlation of classic efficacy/survival criteria with immunphenotypic response: a. Standard response categories: Stringent CR, CR, VGPR, PR b. Time from randomization to second disease progression or the moment when the third line of treatment is initiated. SLP2. c. Overall Survival, Difference in the quality of life scores in the questionnaires EQ-5D/5L, QLQ-C30 and MY20 between initiation and months 6, 12, and 18 during induction therapy, after consolidation, and every 6 months during maintenance., Counts and proportions of treatment-related adverse effects for each treatment arm and in each treatment phase.

Source: https://euclinicaltrials.eu/ctis-public/view/2024-516905-22-00